EU clinical trial 2024-515681-14-00: Temozolomide and irinotecan consolidation in patients with MGMT silenced, microsatellite stable colorectal cancer with persistence of minimal residual disease in liquid biopsy after standard adjuvant chemotherapy: the ERASE-TMZ study
Sponsor: Fondazione IRCCS Istituto Nazionale Dei Tumori (Hospital/Clinic/Other health care facility). Phase: Therapeutic exploratory (Phase II). Countries: Italy (ongoing, recruiting).
Therapeutic area(s): Diseases [C] - Neoplasms [C04]
Gender: Female, Male. Age: 18-64 years, 65+ years. Enrolment: 25.
Status: Ongoing, recruiting. Start date (EU): 2022-05-02. Decision date: 2024-09-30. Results received: No. Last updated: 2025-11-13.

Condition(s): Stage II (pT4)/III colorectal cancer with positive circulating tumor DNA (ctDNA) after oxaliplatin-based adjuvant chemotherapy
Product: TEMOZOLOMIDE, IRINOTECAN

Primary endpoint: The activity of TEMIRI will be measured as the rate of patients with post-treatment seroreversion and disease-free at 2 years
Endpoint(s): Disease-free survival (DFS) of patients treated with TEMIRI as post-adjuvant regimen, defined as the time from enrolment to the first documentation of objective disease relapse determined by investigator assessment or death due to any cause, whichever occurs first, Overaal survival (OS), defined as the time from enrolment to the date of death due to any cause. For patients alive at the time of analysis, the OS time will be censored on the last date the patients were known to be alive, Safety that will be assessed by monitoring the frequency, duration, and severity of AEs through physical examinations, clinical laboratory blood and urine sample evaluations., The analysis of Patient Reported Outcomes (PROs) endpoints (assessed using the EORTC QLQ-C30, the EORTC QLQ-CR29 and the EuroQol EQ-5D questionnaires) will be performed according to the EORTC Scoring and Reference Values Manual. All scores and subscales will be assessed through descriptive summary statistics, To develop a gene expression signature associated with temozolomide resistance/sensitivity by profiling tumor tissue blocks obtained prior to any treatment, To assess the accuracy of liquid biopsies collected during follow-up to predict recurrence

Source: https://euclinicaltrials.eu/ctis-public/view/2024-515681-14-00